EU clinical trial 2022-503110-23-00: Phase IV comparative, randomized, open-label pilot study to evaluate the efficacy and safety of a rilpivirine-based antiretroviral treatment regimen in HIV-infected patients with metabolic liver disease who maintain undetectable HIV viral load
Protocol code: GESIDA 12422
Sponsor: Fundacion Seimc Gesida (Laboratory/Research/Testing facility). Phase: Therapeutic use (Phase IV). Countries: Spain (ended).
Therapeutic area(s): Diseases [C] - Virus Diseases [C02]; Diseases [C] - Digestive System Diseases [C06]
Gender: Female, Male. Age: 18-64 years, 65+ years. Enrolment: 75.
Status: Ended. Start date (EU): 2023-05-05. End date (EU): 2025-07-07. Decision date: 2023-03-29. Results received: Yes. Last updated: 2023-08-28.

Condition(s): Metabolic liver disease in HIV-infected people
Product: Juluca 50 mg/25 mg film-coated tablets, Emtricitabine/Tenofovir disoproxil Tillomed 200 mg/245 mg filmdragerade tabletter, Juluca 50 mg/25 mg film-coated tablets, Truvada 200 mg/245 mg film-coated tablets, Descovy 200 mg/25 mg film-coated tablets, Descovy 200 mg/25 mg film-coated tablets, Truvada 200 mg/245 mg film-coated tablets, Descovy 200 mg/25 mg film-coated tablets, Eviplera 200 mg/25 mg/245 mg film-coated tablets, Tivicay 50 mg film-coated tablets, Truvada 200 mg/245 mg film-coated tablets, Eviplera 200 mg/25 mg/245 mg film-coated tablets, Emtricitabina/Tenofovir disoproxilo Aurovitas 200 mg/245 mg comprimidos recubiertos con película EFG, Tivicay 50 mg film-coated tablets, Odefsey 200 mg/25 mg/25 mg film-coated tablets, Odefsey 200 mg/25 mg/25 mg film-coated tablets, EDURANT 25 mg film-coated tablets

Primary endpoint: no progression and/or regression of liver fibrosis measured by non-invasive tests at month 18, measured as: 1. No change in liver stiffness measured by TE or FIB4 at the 18-month visit from baseline in the intervention group (arms 1 and 2) versus the control group. 2. Reduction in liver stiffness as measured by TE or FIB4 at the 18-month visit from baseline in the intervention group (arms 1 and 2) versus the control group.

Source: https://euclinicaltrials.eu/ctis-public/view/2022-503110-23-00